EU clinical trial 2025-522407-23-00: A Phase IIb, Randomised, Multicentre, Double-Blind Study to Evaluate the Effect of Baxdrostat in Combination with Dapagliflozin Compared with Baxdrostat on Albuminuria in Participants with Chronic Kidney Disease and High Blood Pressure
Protocol code: D6972C00006
Sponsor: AstraZeneca AB (Pharmaceutical company). Phase: Therapeutic exploratory (Phase II). Countries: Spain (ended), Bulgaria (ongoing, recruitment ended).
Therapeutic area(s): Diseases [C] - Cardiovascular Diseases [C14]
Gender: Female, Male. Age: 18-64 years, 65+ years. Enrolment: 28.
Start date (EU): 2026-04-16. Decision date: 2026-02-16. Results received: No. Last updated: 2026-06-03.
Decision dates by country: BG: 2026-02-16, ES: 2026-02-16

Condition(s): Chronic kidney disease (CKD) and hypertension.
Product: Forxiga 10 mg film-coated tablets, Baxdrostat, Dapagliflozin Placebo

Primary endpoint: Change from baseline in UACR at Week 12

Source: https://euclinicaltrials.eu/ctis-public/view/2025-522407-23-00